EU clinical trial 2024-517538-16-00: Effect of Tezepelumab on barrier function in severe asthmatic patients with and without comorbid chronic rhinosinusitis with nasal polyps – an exploratory study
Protocol code: TezeBarrier
Sponsor: Medical University Of Vienna (Educational Institution). Phase: Therapeutic use (Phase IV). Countries: Austria (ongoing, recruiting).
Therapeutic area(s): Diseases [C] - Otorhinolaryngologic Diseases [C09]
Gender: Female, Male. Age: 18-64 years, 65+ years. Enrolment: 20.
Status: Ongoing, recruiting. Start date (EU): 2025-09-25. Decision date: 2025-03-03. Results received: No. Last updated: 2025-03-03.

Condition(s): severe asthma and chronic rhinosinusitis with nasal polyps, severe asthma without chronic rhinosinusitis
Product: TEZEPELUMAB

Primary endpoint: Changes in normalized cell index in response to barrier-damaging substances in cultured primary epithelial cells of the different disease entities using the xCELLigence system for continuous monitoring of barrier function.
Endpoint(s): Mucus plugging: CT scan, Cellular composition: percentage of populations and mean metal intensity (marker expression), Inflammatory mediator expression: Levels (e.g. ng/mL), Microbiome: Composition, Diversity Indices, Tight junction protein staining: mean fluorescence intensity, Association: Pearson or Spearman-rank correlation coefficient depending on data distribution

Source: https://euclinicaltrials.eu/ctis-public/view/2024-517538-16-00